EU clinical trial 2025-520610-58-00: A Phase 3, Randomized, Active-Controlled, Double-Blind Clinical Study to Evaluate the Efficacy and Safety of MK-8527 Oral Once-Monthly as HIV-1 Preexposure Prophylaxis
Protocol code: MK-8527-011
Sponsor: Merck Sharp & Dohme LLC (Pharmaceutical company). Phase: Therapeutic confirmatory (Phase III). Countries: France (ongoing, recruitment ended).
Therapeutic area(s): Diseases [C] - Virus Diseases [C02]
Gender: Female, Male. Age: 0-17 years, 18-64 years, 65+ years. Enrolment: 100.
Status: Ongoing, recruitment ended. Start date (EU): 2025-11-19. Decision date: 2025-10-03. Results received: No. Last updated: 2026-07-06.

Condition(s): HIV-1 prevention
Product: Placebo for Emtricitabine/Tenofovir Disoproxil, Placebo for MK-8527, TENOFOVIR DISOPROXIL AND EMTRICITABINE, MK-8527 F1

Primary endpoint: Number of Participants With Adjudicated Human Immunodeficiency Virus Type 1(HIV-1) Infection, Number of Participants Who Experience At Least One Adverse Event (AE), Number of Participants Who Discontinue Study Intervention Due to an AE

Source: https://euclinicaltrials.eu/ctis-public/view/2025-520610-58-00